EU clinical trial 2024-519227-22-00: Fedratinib in Combination with CC-486, a Hypomethylating Agent, in Patients with Accelerated Phase Myelofibrosis - FAMy
Protocol code: KKSH178
Sponsor: Martin-Luther-Universitaet Halle-Wittenberg (Educational Institution). Phase: Phase I and Phase II (Integrated)- Other. Countries: Germany (ended).
Therapeutic area(s): Diseases [C] - Neoplasms [C04]
Gender: Female, Male. Age: 18-64 years, 65+ years. Enrolment: 44.
Status: Ended. Start date (EU): 2022-11-03. End date (EU): 2026-04-16. Decision date: 2024-12-13. Results received: No. Last updated: 2025-11-20.

Condition(s): Myeloproliferative neoplasm in accelerated phase (MPN-AP)
Product: Inrebic 100 mg hard capsules, Onureg 200 mg film coated tablets, Onureg 300 mg film coated tablets

Primary endpoint: Phase I: physical examinations, laboratory tests, AEs, serious AEs (SAEs), ECGs, and vital signs. - DLTs (dose limiting toxicity) will be used to establish the MTD of fedratinib in combination with CC-486. The SRC will determine the RP2D and schedule based on safety data of the combination of fedratinib and CC-486. Phase II: - Best response to the combination therapy at week 24 according to the IWG-MRT and the ELN consensus report. This includes CI, PR and CR
Endpoint(s): duration of response - Change in MF-associated symptoms measured by MFSAF - Time from the first observation of best symptom response to first documented loss of symptom response - Spleen response by palpation - Time from the first treatment dose to disease progression, relapse or death - proportion of subjects who transit to allogeneic SCT - proportion of subjects that demonstrate an anemia - Analysis of incidence of subjects with a CTCAE Grade ≥3 of nausea, diarrhea, vomiting or occurrence o

Source: https://euclinicaltrials.eu/ctis-public/view/2024-519227-22-00